EU clinical trial 2023-509848-10-00: A Phase 3, Multicenter, Randomized, Open-label Study to Compare the Efficacy and Safety of bb2121 Versus Standard Regimens in Subjects with Relapsed and Refractory Multiple Myeloma (RRMM) (KarMMa-3)
Protocol code: BB2121-MM-003
Sponsor: Celgene Corp. (Pharmaceutical company). Phase: Therapeutic confirmatory (Phase III). Countries: Germany (ended), Spain (ended), Italy (ended), France (ended), Netherlands (ended), Belgium (ended), Norway (ended).
Therapeutic area(s): Diseases [C] - Neoplasms [C04]
Gender: Female, Male. Age: 18-64 years, 65+ years. Enrolment: 138.
Status: Ended. Start date (EU): 2019-06-12. End date (EU): 2026-04-01. End date: 2026-04-13. Decision date: 2024-06-10. Results received: No. Last updated: 2026-03-16.
Decision dates by country: DE: 2024-06-12, IT: 2024-06-17, NO: 2024-06-13, FR: 2024-06-10, ES: 2024-06-11, NL: 2024-06-14, BE: 2024-06-11

Condition(s): Multiple myeloma (MM) with at least 2 prior therapies including an immunomodulatory (IMiD) compound and a proteasome inhibitor (PI) and demonstrated disease progression on or within 60 days of completion of the last therapy.
Product: Dexamethason CF 20 mg/ml, injectievloeistof, Imnovid 4 mg hard capsules, ELOTUZUMAB, VELCADE 3.5 mg powder for solution for injection, IXAZOMIB, Dexamethason 4 mg JENAPHARM®, Kyprolis 30 mg powder for solution for infusion, Imnovid 1 mg hard capsules, Imnovid 2 mg hard capsules, Imnovid 3 mg hard capsules, Revlimid 15 mg hard capsules, IXAZOMIB, idecabtagene vicleucel, DARZALEX 20 mg/mL concentrate for solution for infusion, Revlimid 10 mg hard capsules, IXAZOMIB, Revlimid 5 mg hard capsules, Revlimid 25 mg hard capsules, Dexamethasone Tablets BP 2.0mg

Primary endpoint: Progression-free survival (PFS)
Endpoint(s): Overall Response Rate (ORR), Overall Survival (OS), Event-free Survival (EFS), Minimal Residual Disease (MRD), Complete Response (CR) Rate, Duration of Response (DOR), Time to Response (TTR), Safety, Pharmacokinetics (PK) – bb2121, Primary Domains of Interest Health Related Quality of Life (HRQoL), Time to next anti-myeloma treatment, Progression-free survival after next line therapy (PFS2)

Source: https://euclinicaltrials.eu/ctis-public/view/2023-509848-10-00